EU clinical trial 2025-523370-16-00: A Phase 1, Multi-Cohort, Open-Label, Randomized Pilot Study to Evaluate the Effect of Food and a Proton-Pump Inhibitor (esomeprazole) on the Single-Dose Pharmacokinetics of ARV-102 in Healthy Participants.
Protocol code: ARV-102-105
Sponsor: Arvinas Operations Inc. (Pharmaceutical company). Phase: Human Pharmacology (Phase I)- Other. Countries: Netherlands (ended).
Therapeutic area(s): Diseases [C] - Nervous System Diseases [C10]
Gender: Female, Male. Age: 18-64 years. Enrolment: 24.
Status: Ended. Start date (EU): 2025-11-17. End date (EU): 2026-01-22. End date: 2026-01-23. Decision date: 2025-11-14. Results received: No. Last updated: 2025-11-14.

Condition(s): Parkinsonian syndromes

Source: https://euclinicaltrials.eu/ctis-public/view/2025-523370-16-00